EU clinical trial 2022-502812-35-00: A Multicenter, Extension Study to Evaluate the Efficacy, Safety, Pharmacokinetics, and Pharmacodynamics of Two Doses of Linsitinib in Subjects with Active, Moderate to Severe Thyroid Eye Disease (TED)
Protocol code: VGN-TED-302
Sponsor: Sling Therapeutics Inc. (Pharmaceutical company). Phase: Therapeutic exploratory (Phase II). Countries: Spain (ended), Italy (ended).
Therapeutic area(s): Diseases [C] - Eye Diseases [C11]
Gender: Female, Male. Age: 18-64 years, 65+ years. Enrolment: 6.
Status: Ended. Start date (EU): 2023-10-26. End date (EU): 2025-06-06. Decision date: 2023-07-21. Results received: No. Last updated: 2025-07-25.
Decision dates by country: ES: 2023-07-21, IT: 2023-07-21

Condition(s): Thyroid Eye Disease
Product: Placebo to match 75 mg linsitinib film-coated tablet. Placebo tablets are formulated to match the physical characteristics of the active tablets. The placebo drug product is a tablet formulation compressed from a direct powder blend containing microcrystalline cellulose, lactose monohydrate, and magnesium stearate.

Primary endpoint: Proptosis responder rate at Extension study Week 24. The definition of responder rate, unchanged from the main VGN-TED-301 study, is the percentage of subjects with a ≥ 2 mm reduction from Baseline in the primary study eye without deterioration (≥ 2 mm increase) of proptosis in the contralateral non-study eye.
Endpoint(s): 1. Mean change from Baseline through Week 24 in proptosis measurement in the primary study eye. 2. Overall responder rate (percentage of subjects with ≥ 2-point reduction in Clinical Activity Scale (CAS) and ≥ 2mm reduction in proptosis from Baseline, provided there is no corresponding deterioration (≥ 2- point/ mm increase) in CAS or proptosis in the contralateral non-study eye through Week 24.

Source: https://euclinicaltrials.eu/ctis-public/view/2022-502812-35-00